EU clinical trial 2024-513765-40-00: Acute effects of SGLT2 inhibitor on kidney allograft oxygen tension: A randomized, double-blind, placebo controlled crossover trial
Sponsor: Odense University Hospital (Hospital/Clinic/Other health care facility). Phase: Therapeutic exploratory (Phase II). Countries: Denmark (ended).
Therapeutic area(s): Not possible to specify
Gender: Female, Male. Age: 18-64 years, 65+ years. Enrolment: 8.
Status: Ended. Start date (EU): 2025-03-27. End date (EU): 2025-09-09. Decision date: 2025-01-21. Results received: Yes. Last updated: 2025-01-21.

Condition(s): Kidney transplant recipients
Product: Jardiance 25 mg film-coated tablets, Placebo with no active substance and produces by the hospital pharmacy

Primary endpoint: • Kidney allograft cortical and medullary oxygen tension, estimated by BOLD-MRI based renal T2* relaxation rate.
Endpoint(s): • Renal cortical and medullary perfusion ml/100 g/min, • Renal artery blood flow ml/min, • Blood glucose mmol/L, • Systolic blood pressure (SysBP) and diastolic blood pressure (DiaBP) mmHg, • Heart rate (HR), beats min-1

Source: https://euclinicaltrials.eu/ctis-public/view/2024-513765-40-00